EU clinical trial 2024-514303-34-00: A first-in-human (FIH) clinical trial to investigate the human monoclonal antibody NG004, administrated intrathecally in acute spinal cord injury (SCI) patients
Protocol code: NG004-SCI-001
Sponsor: NovaGo Therapeutics AG (Pharmaceutical company). Phase: Human Pharmacology (Phase I)- First administration to humans. Countries: Germany (ongoing, recruiting).
Therapeutic area(s): Diseases [C] - Nervous System Diseases [C10]
Gender: Female, Male. Age: 18-64 years, 65+ years. Enrolment: 19.
Status: Ongoing, recruiting. Start date (EU): 2024-12-18. Decision date: 2024-11-14. Results received: No. Last updated: 2026-03-09.

Condition(s): Acute Incomplete Cervical Spinal Cord Injury
Product: NG004_DS2.1, NG004_DS1, NG004_DS3.1, NG004_DS4

Primary endpoint: Type, frequency, severity, and causal relationship of adverse events (AEs), serious AEs (SAEs), and adverse drug reactions (ADRs), Safety laboratory, electrocardiogram (ECG), vital signs, physical and neurological examination, muscle spasticity (Modified Ashworth Scale), and pain (condensed version of the EMSCI Pain Assessment Form [NePAF])
Endpoint(s): PK parameter in serum and NG004 concentration in cerebrospinal fluid (CSF)

Source: https://euclinicaltrials.eu/ctis-public/view/2024-514303-34-00